EU clinical trial 2023-506647-42-00: Psilocybin in alcohol use disorder with comorbid depression - Randomized double-blind controlled pilot study.
Protocol code: IRESP/2022/AL-01
Sponsor: Centre Hospitalier Universitaire De Nimes (Hospital/Clinic/Other health care facility). Phase: Therapeutic exploratory (Phase II). Countries: France (ended).
Therapeutic area(s): Psychiatry and Psychology [F] - Mental Disorders [F03]
Gender: Female, Male. Age: 18-64 years, 65+ years. Enrolment: 30.
Status: Ended. Start date (EU): 2024-02-05. End date (EU): 2025-03-05. Decision date: 2023-12-20. Results received: Yes. Last updated: 2024-03-21.

Condition(s): alcohol use disorder
Product: PSILOCYBINE, PSILOCYBINE

Primary endpoint: Collection of the number of patients who completed the two Psilocybin intake sessions out of the two planned as an approximation of feasibility.
Endpoint(s): Number of patients screened per month/number of patients included per month. Average time (days) between screening and inclusion. Rate (%) of eligible patients included in the study. Rate (%) of included patients who had at least one treatment session. Rate (%) of assessment sessions performed. Duration of assessment sessions (min)., Number of patients leaving the study prematurely for any reason. Collection of reasons for patient drop-out., Decrease in percentage of heavy drinking days in last 4 weeks prior to week 6 (or discharge if later; S6) and at week 12 (S12) vs. baseline (last 4 weeks drinking period). Total alcohol consumption in the last 4 weeks prior to week 6 (or discharge if later) and at week 12 compared with baseline (consumption period in last 4 weeks). Time to first drink (days). Time to first day of heavy drinking (days)., Craving Experience Questionnaire (CEQ) scores at D0 and W12., Alcohol quality of life scale (AQoLS; 56) scores at D0 and W12., Scores on the Beck Depression Inventory (BDI II), Beck Anxiety Inventory (BAI), Difficulties in Emotion Regulation Scale (DERS), Adult Rejection Sensitivity Questionnaire (A-RSQ) and Meaning in Life Questionnaire (MLQ) at D0, W3, W6 and W12., Conflict indices and focus on the Visual Perspective Task (VPT) at D0 and Int2., Factors assessed at D0: Adverse Childhood Events (ACE), Montreal Cognitive Assessment (MoCA), Posttraumatic Stress Disorder Checklist for DSM-5 (PCL-5), Relationship Scale Questionnaire (RSQ) attachment score.), Collection of other drug treatments by class., 5D-ASC (5-Dimensional Altered States of Consciousness Questionnaire) scores at the end of Psilo1 and Psilo2. EEG parameters recorded before the first psilocybin administration (resting state), during the 1st administration (at the expected peak of the psychedelic effect) and during the integration session the day after the second psilocybin administration (resting state). Qualitative analysis of the verbatim of the integration session., Blood sampling and determination of circulating 16sDNA, permeability and inflammation markers, microbiota analysis, Blood sampling and plasma marker analysis: cytokine immunoassay (TNFα, IL-1β, IL-6, IL-8, IL-10, MCP-1), epitranscriptomic mass spectrometry, blood proteome, biomarker discovery, Study brain anatomical anomalies and volume differences in certain brain regions.

Source: https://euclinicaltrials.eu/ctis-public/view/2023-506647-42-00